EU clinical trial 2024-511312-24-00: Peripheral Edema Resolution evaluated in patients switched from amlodipine to Levamlodipine (PERLA)
Protocol code: PERLA
Sponsor: Zentiva k.s. (Pharmaceutical company). Phase: Therapeutic exploratory (Phase II). Countries: Czechia (ended).
Therapeutic area(s): Diseases [C] - Cardiovascular Diseases [C14]
Gender: Female, Male. Age: 18-64 years, 65+ years. Enrolment: 60.
Status: Ended. Start date (EU): 2024-09-25. End date (EU): 2025-07-31. Decision date: 2024-06-10. Results received: Yes. Last updated: 2025-04-10.

Condition(s): Patients with moderate or severe oedema on a long-term treatment with amlodipine
Product: S-Amlodipine TAB (VAM) 1.25 mg, Amlodipine 2.5 mg

Primary endpoint: • Change from baseline to end of Period 2 visit of AFV by the water displacement method.
Endpoint(s): Efficasy: • Change from baseline to end of Period 1 and 3 visit of AFV by the water displacement., Efficasy: • Change from baseline to end of Period 1 (2, 3) visit of the ankle circumference by figure-of-eight method., Efficasy: • Semiquantitative edema scoring in both feet by the investigator at each visit., Efficasy: • Patient reported questionnaire., Additional endpoints: • Number of IMP taken and reported in patient’s diary., Additional endpoints: • Total number (count) of returned IMP., Safety: • Vital signs (SBP, DBP, heart rate, body temperature), and physical examination at each trial visit, Safety: • Incidence of AEs during the entire trial, Safety: • Laboratory examination (on screening visit)

Source: https://euclinicaltrials.eu/ctis-public/view/2024-511312-24-00